EU clinical trial 2022-502268-18-00: I5T-MC-AACQ: Investigating the Effect of Different Donanemab Dosing Regimens on ARIA-E and Amyloid Lowering in Adults with Early Symptomatic Alzheimer’s Disease
Protocol code: I5T-MC-AACQ
Sponsor: Eli Lilly & Co. (Pharmaceutical company). Phase: Therapeutic confirmatory (Phase III). Countries: Italy (ended).
Therapeutic area(s): Diseases [C] - Nervous System Diseases [C10]
Gender: Female, Male. Age: 65+ years. Enrolment: 56.
Status: Ended. End date (EU): 2024-03-19. Decision date: 2023-04-07. Results received: No. Last updated: 2023-04-07.

Condition(s): Neurocognitive Disorders, Central Nervous System Diseases, Neurodegenerative Diseases, Nervous System Diseases, Dementia, Alzheimer’s Disease, Brain Diseases, Mental Disorders
Product: Neuraceq 300 MBq/mL solution for injection, SODIUM CHLORIDE, Donanemab

Primary endpoint: Percentage of Participants with Any Occurrence of Amyloid-Related Imaging Abnormality-Edema/Effusion (ARIA-E)

Source: https://euclinicaltrials.eu/ctis-public/view/2022-502268-18-00